EU clinical trial 2023-509003-32-00: Vancomycin treatment in critically ill adults using model-informed precision dosing tool – prospective low-intervention clinical trial. (ProVanc)
Protocol code: PROVANC1.0
Sponsor: Tartu University Hospital (Hospital/Clinic/Other health care facility). Phase: Therapeutic use (Phase IV). Countries: Estonia (ended).
Therapeutic area(s): Diseases [C] - Bacterial Infections and Mycoses [C01]
Gender: Female, Male. Age: 18-64 years, 65+ years. Enrolment: 56.
Status: Ended. Start date (EU): 2024-03-01. End date (EU): 2026-02-01. Decision date: 2024-01-12. Results received: No. Last updated: 2024-12-02.

Condition(s): Serious infections where according to the treating physician's decision treatment with intravenous vancomycin is needed.
Product: VANCOMYCIN HYDROCHLORIDE

Primary endpoint: The proportion of patients that stay in the vancomycin therapeutic target range (AUC24 400-600 µg/ml x h) 70% of time when dose is optimised using the model selection and model-informed precision dosing tool developed by our study group
Endpoint(s): Median proportion of time during vancomycin treatment spent within the vancomycin therapeutic target range AUC24 400-600 µg/mL x hr, Proportion of patients who achieve the treatment goal of AUC24 400-600 µg/mL x hr during the first 24h, Proportion of patients who achieve the treatment goal of AUC24 400-600 µg/mL x hr between 24-48h after the initiation of treatment with vancomycin, Proportion of patients with average AUC24 in target range, Mortality at the discharge from 3rd level intensive care unit, Length of hospitalisation and stay in the third level ICU, Length of vancomycin treatment, Attainment of clinical cure, defined as survival and completion of the antibiotic therapy course without addition of or switch to another antibiotic therapy and no start of a new antibiotic assessed at the study end visit, Clinical outcome by the end of study defined as following: dead, alive in ICU, referred to home, referred to another hospital ward, The cumulative vancomycin dose, Corresponding vancomycin AUC24 and Ctrough during the treatment period, Occurrence and worsening of acute kidney injury (according to the KDIGO AKI criteria) during vancomycin treatment, Percentage of measured vancomycin Ctrough values exceeding 20 mg/L, Proportion of time spent above the recommended AUC24 >600 µg/mL x hr, The proportion of Ctrough values under, over or in the target ranges (<10 mg/L, 10-20 mg/L, 10-15 mg/L, 15-20 mg/L, >20 mg/L) compared to corresponding AUC24

Source: https://euclinicaltrials.eu/ctis-public/view/2023-509003-32-00